EU clinical trial 2024-518474-14-00: The effect of phoSPHocreatine on mEdical emergency team (met) tREated patients: a randomized clinical trial protocol – SPHERE
Protocol code: GR-2021-12375001
Sponsor: Ospedale San Raffaele S.r.l. (Hospital/Clinic/Other health care facility). Phase: Therapeutic confirmatory (Phase III). Countries: Italy (authorised, recruitment pending).
Therapeutic area(s): Diseases [C] - Nervous System Diseases [C10]; Diseases [C] - Cardiovascular Diseases [C14]; Diseases [C] - Respiratory Tract Diseases [C08]
Gender: Female, Male. Age: 18-64 years, 65+ years. Enrolment: 350.
Status: Authorised, recruitment pending. Decision date: 2024-11-18. Results received: No. Last updated: 2026-04-22.

Condition(s): respiratory arrest, threatened airways, tachycardia, bradypnea, pulse rate < 40 or > 140 bpm, sudden fall in level of counciousness, tachypnea, systolic blood pressure < 90 mmHg, fall in Glasgow Coma Scale of > 2 points
Product: Neoton Phlebo 1 g prášek pro infuzní roztok, Sodio cloruro Fresenius Kabi Italia 0,9%, soluzione per infusione

Primary endpoint: How to calculate DAH30 (days alive and out-of-hospital at day 30): Has patient died in hospital or after discharge on any day within the first 30-days after randomization? If YES we will give 0 points Is the patient discharged from hospital on Day 5 after randomization but is subsequently readmitted for 5-days before their second hospital discharge? If YES we will give 20 points Is patient in a post- discharge nursing facility? If YES: we won’t consider as days at home.

Source: https://euclinicaltrials.eu/ctis-public/view/2024-518474-14-00